EU clinical trial 2023-507357-15-01: Randomized, parallel-group, double-blind clinical trial to evaluate the efficacy and safety of PRGF eye drops in patients with dry eye disease
Protocol code: BTIIMD-02-EC-23-OJOS
Sponsor: Biotechnology Institue I Mas D S.L. (Pharmaceutical company). Phase: Therapeutic use (Phase IV). Countries: Spain (authorised, recruitment pending).
Therapeutic area(s): Diseases [C] - Eye Diseases [C11]
Gender: Female, Male. Age: 18-64 years, 65+ years. Enrolment: 54.
Status: Authorised, recruitment pending. Decision date: 2025-05-26. Results received: No. Last updated: 2026-05-26.

Condition(s): Dry Eye Disease
Product: Artific 3,20 mg/ml colirio en solución, Hidrathea 9 mg/ml colirio en solución, Plasma rich in growth factors

Primary endpoint: Efficacy: - Subjective evolution of patients' symptomatology using the OSDI questionnaire at 12 weeks. - Change in ocular surface staining at 12 weeks using the Oxford scale., Safety: • Global tolerance assessed by the investigator at 2 and 12 weeks. • Patient-assessed global tolerance at 2 and 12 weeks. • Adverse events mentioned throughout the study, both ocular and systemic. • Ocular adverse events (AEs). • - Systemic adverse events (AEs)
Endpoint(s): Demographic variables - Patient code - Age - Sex - Toxic habits (smoking, alcohol), Clinical variables - Diagnosed with Sjögren's disease (primary or secondary) - Diagnosed with Rosacea - Personal and ophthalmologic history - Previous medication, Efficacy: - Subjective evolution of patients' symptomatology using the OSDI questionnaire at 2 weeks. - Change in ocular surface staining at 2 weeks using the Oxford scale. - Change in global pathology symptoms with respect to severity and frequency at 2 and 12 weeks using the Visual Analog Scale (VAS). - Change in best corrected visual acuity (LogMAR VA) at 2 and 12 weeks., Efficacy: - Change in tear quantity at 2 and 12 weeks using Schirmer's test. - Change in time to tear film breakage (TBUT) at 2 and 12 weeks. - Intraocular pressure (IOP) at 2 and 12 weeks.

Source: https://euclinicaltrials.eu/ctis-public/view/2023-507357-15-01